EU clinical trial 2024-517955-10-00: A DOUBLE-BLIND, RANDOMIZED, PLACEBO-CONTROLLED, PHASE I STUDY TO ASSESS THE SAFETY, TOLERABILITY, AND PHARMACOKINETICS OF SINGLE ANDMULTIPLE ASCENDING DOSES OF THN391 IN HEALTHY SUBJECTS
Protocol code: THN391-101
Sponsor: Therini Bio Inc. (Laboratory/Research/Testing facility). Phase: Human Pharmacology (Phase I)- First administration to humans. Countries: Netherlands (ended).
Therapeutic area(s): Diseases [C] - Nervous System Diseases [C10]
Gender: Female, Male. Age: 18-64 years. Enrolment: 96.
Status: Ended. Start date (EU): 2023-04-05. End date (EU): 2025-06-20. Decision date: 2024-10-15. Results received: No. Last updated: 2024-10-15.

Condition(s): Healthy volunteers

Source: https://euclinicaltrials.eu/ctis-public/view/2024-517955-10-00